EU clinical trial 2024-516622-57-00: Multicenter, Open Label, Phase 3 Study of Tabelecleucel for Solid Organ or Allogeneic Hematopoietic Cell Transplant Subjects with Epstein-Barr VirusAssociated Post-Transplant Lymphoproliferative Disease after Failure of Rituximab or Rituximab and Chemotherapy (ALLELE Study)
Protocol code: ATA129-EBV-302
Sponsor: Pierre Fabre Medicament (Pharmaceutical company). Phase: Therapeutic confirmatory (Phase III). Countries: Belgium (ongoing, recruitment ended), Spain (ongoing, recruiting), Italy (ended), Austria (ongoing, recruitment ended), France (ended).
Therapeutic area(s): Diseases [C] - Immune System Diseases [C20]
Gender: Female, Male. Age: 0-17 years, 18-64 years, 65+ years. Enrolment: 26.
Start date (EU): 2020-05-06. Decision date: 2024-09-27. Results received: No. Last updated: 2026-07-10.
Decision dates by country: FR: 2024-10-21, IT: 2024-10-28, BE: 2024-09-27, ES: 2024-10-03, AT: 2024-10-07

Condition(s): Epstein-Barr Virus-Associated Post-Transplant Lymphoproliferative Disease
Product: EBVALLO

Primary endpoint: ORR (CR or PR) obtained following administration of tabelecleucel with up to 2 different HLA restrictions in each of the following analysis cohorts: • SOT • HCT • A combined population (SOT-R-Ci, SOT-R+C, and HCT) following administration of commercial product or a product manufactured using a comparable PV
Endpoint(s): DOR in the SOT and HCT cohorts separately., ORR and DOR in SOT and HCT cohorts combined., ORR and DOR in subjects who received commercial product or a product manufactured using a comparable PV in the following: SOT-R-Ci and SOT-R+C combined, and separately, HCT, DOR in a combined population (SOT-R-Ci, SOT-R+C, and HCT) who received commercial product or a product manufactured using a comparable PV, Rates of CR and PR, Time to response and time to best response, OS, Rates of allograft loss/rejection episodes (for SOT cohort only)

Source: https://euclinicaltrials.eu/ctis-public/view/2024-516622-57-00